EU clinical trial 2025-522558-37-00: COMPASS - COpenhagen MenoPAuSe Study
Sponsor: Region Hovedstaden (Hospital/Clinic/Other health care facility). Phase: Therapeutic exploratory (Phase II). Countries: Denmark (authorised, recruitment pending).
Therapeutic area(s): Diseases [C] - Hormonal diseases [C19]; Phenomena and Processes [G] - Physiological processes [G07]
Gender: Female. Age: 18-64 years, 65+ years. Enrolment: 200.
Status: Authorised, recruitment pending. Decision date: 2025-08-20. Results received: No. Last updated: 2026-02-27.
Decision dates by country: DK: 2025-09-16

Condition(s): Menopause
Product: The Capital Region's pharmacy has made a placebo gel for the trial., Pamorelin, depotinjektionsvæske, pulver og solvens til suspension, 11,25 mg, ESTREVA® 0,1 % Gel, Tostran, 20 mg/g transdermal gel., Natriumklorid 9 mg/ml "Fresenius Kabi", solvens til parenteralt brug

Primary endpoint: Change in bone remodeling defined by change in bone markers from baseline to week 8
Endpoint(s): Change in serum levels of Hypothalamic–Pituitary–Adrenal (HPA) axis, Hypothalamic-Pituitary-Gonadal (HPG) axis, and Hypothalamic–Pituitary–Thyroid (HPT) axis from baseline to week 8, Change in quality of life evaluated with MENQOL-1 from baseline to week 8, Change in sexual function evaluated with female sexual function index, and female sexual distress scale-revised from baseline to week 8, Change in depressive symptoms evaluated by MDI and CES-D from baseline to week 8, Change in anxiety symptoms evaluated by GAD-7 from baseline to week 8, Change in The Mean Patient-reported Outcomes Measurement Information System Sleep Disturbance - Short Form 8b (PROMIS SD SF 8b) from baseline to week 8, Change in thyroid hormones from baseline to week 4 and 8, Change in urine minerals (calcium, creatinine, phosphate, magnesium, sodium) from baseline to weeks 4 and 8, Change in mineral homeostasis (serum ionized calcium, calcium, albumin, PTH, phosphate, albumin, vitamin D metabolites) from baseline to week 4 and 8, Change in serum hCG from baseline to week 4 and 8, Change in thyroid hormone conversion (DIO2 activity) in fat cells determined by their conversion of T4 to T3 from baseline to week 8, Change in adrenal hormones from baseline to week 4 and 8, Change in the mean frequency of moderate to severe VMS from Baseline to week 8, Change in the mean frequency of moderate to severe VMS from Baseline to week 4, Change in the mean severity-score from Baseline to week 8, Change in the mean severity-score from Baseline to week 4, Change in VMS measured using the questionnaire ‘GCS’ from baseline to week 8, Change in serum LH and FSH from baseline to weeks 4 and 8, Change in serum estradiol and SHGB from baseline to week 4 and 8, Change in fasting insulin from baseline to week 8, Change in HbA1C and HOMA-IR from baseline to week 8, Change in total cholesterol, cholesterol (total, HDL, LDL), and triglycerides from baseline to week 4 and 8, Change in RANKL from baseline to weeks 4 and 8, Change in kidney function (serum creatinine, sodium, potassium, urea) from baseline to week 4 and 8, Change in hepatic enzymes (ALAT, ASAT, GGT, alkaline phosphatase) from baseline to week 4 and 8, Change in QTc using electrocardiogram (ECG) at baseline to week 8, Change in weight at baseline to week 8, Change in RNA expression (RNAseq) in abdominal fat (abdominal fat biopsies) from baseline to week 8 and following in vitro stimulation with hormones and treatments such as LH/hCG, Change in Cerebral Spinal Fluid (CSF) hormone, mineral or neuropeptide levels between all 4 treatment arms at week 8, Change in frequency and type of reported adverse events between baseline and week 4 and 8

Source: https://euclinicaltrials.eu/ctis-public/view/2025-522558-37-00